EU clinical trial 2024-516255-41-00: Contribution of ICG Angiography in the Detection of Parathyroids and the Prevention of Hypoparathyroidism Post Total Thyroidectomy (HYPOCAAVI)
Protocol code: 29BRC20.0208
Sponsor: Centre Hospitalier Regional Et Universitaire De Brest (Hospital/Clinic/Other health care facility). Phase: Therapeutic confirmatory (Phase III). Countries: France (authorised, recruiting).
Therapeutic area(s): Diseases [C] - Hormonal diseases [C19]
Gender: Female, Male. Age: 18-64 years, 65+ years. Enrolment: 242.
Status: Authorised, recruiting. Start date (EU): 2024-07-31. Decision date: 2024-07-31. Results received: No. Last updated: 2024-07-31.

Condition(s): Thyroid Diseases; Hypoparathyroidism; Hypocalcemia
Product: INFRACYANINE 25 mg/10 mL, poudre et solvant pour solution injectable

Primary endpoint: Occurrence (yes/no) of albumin-corrected hypocalcaemia (≤2 mmol/L) within 48 hours of surgery
Endpoint(s): Occurrence (yes/no) of post-operative hypocalcaemia corrected by albumin (<2mmol/L) at D8, M1 and M6, Modification (yes/no) of the surgical procedure by improving detection of the parathyroids or their vascularisation during thyroidectomy with the use of indocyanine green angiography, Intraoperative parathyroid vitality score when using indocyanine green angiography, Occurrence (yes/no) of hypoPTH on D1 and D2 post-op (<10ng/L), Occurrence (yes/no) of mild (asymptomatic and >1.7mmol/l), moderate (symptomatic and >1.7mmol/l) and profound (<1.7mmol/l) hypocalcaemia in the 48 postoperative hours, Occurrence of an adverse reaction linked to the injection of indocyanine green

Source: https://euclinicaltrials.eu/ctis-public/view/2024-516255-41-00